EU clinical trial 2022-502811-12-00: A Multicenter, Randomized, Placebo-Controlled, Double-Blind, Adaptive Phase 3 Study to Evaluate the Efficacy and Safety of Sinecatechins (Defined Extract of Green Tea Leaves) Ointment in Adult Patients with Actinic Keratosis of the Scalp and the Face.
Protocol code: Pro_VER-01-21_AR
Sponsor: Aresus Pharma GmbH (Pharmaceutical company). Phase: Therapeutic confirmatory (Phase III). Countries: Germany (ongoing, recruiting).
Therapeutic area(s): Diseases [C] - Skin and Connective Tissue Diseases [C17]
Gender: Female, Male. Age: 18-64 years, 65+ years. Enrolment: 280.
Status: Ongoing, recruiting. Start date (EU): 2024-09-04. Decision date: 2023-10-18. Results received: No. Last updated: 2026-05-28.

Condition(s): Actinic Keratosis (AK) of the Scalp and/or the Face.
Product: Veregen 10% Salbe, Placebo to Veregen® 10% Ointment: it is a brown, smooth ointment, free from gritty particles manufactured to match the verum ointment in colour, amount of material in the primary container and appearance.

Primary endpoint: Efficacy Endpoint: Complete clinical clearance of the TA following a treatment period of 12 weeks and a 4-weeks PT period. [Complete (100%) clinical clearance is defined as complete disappearance of all clinically visible and/or palpable AK lesions in the TA; Total number of AK lesions (TN) = 0]
Endpoint(s): Efficacy Endpoints - Clinical Clearance, During the interventional study period: Complete (100%; TN = 0) clinical clearance of the TA at every on-site visit during the treatment period (i.e. at 2, 4, 8 and 12 weeks of treatment) and at 4-weeks PT (for patients without complete clearance at EoT)., Efficacy Endpoints - Clinical Clearance, During the interventional study period: Time to complete clinical clearance during the course of the study (defined as the on-site visit at which complete clinical clearance of the TA is seen for the first time), Efficacy Endpoints - Clinical Clearance, During the interventional study period: At least 75% clinical clearance of the TA at every on-site visit during the treatment period (i.e. at 2, 4, 8 and 12 weeks of treatment) and at 4-weeks PT. [75% clinical clearance is achieved if the number of all clinically visible and/or palpable AK lesions is reduced by 75% compared to TN at Baseline], Efficacy Endpoints - Lesion count, During the interventional study period: TN in the TA at every on-site visit during the treatment period and at 4-weeks PT and mean change in TN from Baseline., Efficacy Endpoints - Lesion count, During the interventional study period: Number of new AK lesions (not present at baseline) in the TA at every on-site visit during the treatment period and at 4-weeks PT and mean change in number of new AK lesions from Baseline., Efficacy Endpoints - Lesion count, During the interventional study period: Number of baseline AK lesions that remain present in the TA at every on-site visit during the treatment period and at 4-weeks PT and mean change in number of baseline AK lesions from Baseline., Efficacy Endpoints - AK severity grading, During the interventional study period: AK severity of the head (acc. to Olsen, modified acc. to Stockfleth) at Baseline and End of Treatment and mean change in AK severity of the head from Baseline., Efficacy Endpoints - AK severity grading, During the interventional study period: AK severity of the TA (acc. to Olsen, modified acc. to Stockfleth and acc. to local AKASI) at every on-site visit during the treatment period and at 4-weeks PT and mean change in AK severity of TA from Baseline., Efficacy Endpoints - AK severity grading, During the interventional study period: Change in Erythema (E) intensity and degree of thickness (T) (acc. to corresponding AKASI subscores) of all individual AK lesions present at every on-site visit during the treatment period and at 4-weeks PT., Efficacy Endpoints - Clinical Clearance, During the post-treatment FU: Complete clinical clearance of TA (i.e., TN = 0) at every on-site visit during a 1-year post-treatment follow-up period (PTFU) (i.e. at 8 weeks PT, 3, 6, 9 and 12 months PT)., Efficacy Endpoints - Clinical Clearance, During the post-treatment FU: At least 75% clinical clearance at every on-site visit during a 1-year PTFU., Efficacy Endpoint - Lesion count, During the post-treatment FU: TN in the TA at every on-site visit during a 1-year PTFU and mean change in TN from the End of Treatment (EoT) visit., Efficacy Endpoint - Lesion count, During the post-treatment FU: Number of new AK lesions (not present at baseline) in the TA at every on-site visit during a 1-year PTFU and mean change in number of new AK lesions from the EoT visit., Efficacy Endpoint - Lesion count, During the post-treatment FU: Number of baseline AK lesions that remain present in the TA at every on-site visit during a 1-year PTFU and mean change in number of baseline AK lesions from the EoT visit., Efficacy Endpoint - AK severity grading, During the post-treatment FU: AK severity of the head (acc. to Olsen, modified acc. to Stockfleth) at every on-site visit during a 1-year PTFU and mean change in AK severity of the head from the EoT visit., Efficacy Endpoint - AK severity grading, During the post-treatment FU: AK severity of the TA (acc. to Olsen, modified acc. to Stockfleth and acc. to local AKASI) at every on-site visit during a 1-year PTFU and mean change in AK severity of the TA from the EoT visit., Efficacy Endpoint - AK severity grading, During the post-treatment FU: Change in Erythema (E) intensity and degree of thickness (T) (acc. to corresponding AKASI subscores) of all individual AK lesions present at every on-site visit during a 1-year PTFU., Efficacy Endpoint - Reoccurrence: Proportion of patients with recurrence of AK (i.e. TN > 0) in the TA at every on-site visit after complete clinical clearance., Efficacy Endpoint - Reoccurrence: Extent of recurrence (defined as the mean number of clinically visible and/or palpable AK lesions in the TA at every on-site visit after complete clinical clearance)., Efficacy Endpoint - Reoccurrence: Time to recurrence (defined as on-site visit at which the first clinically visible and/or palpable AK lesion is detected in the TA after complete clinical clearance)., Safety Endpoint - During the interventional study: Adverse events/serious adverse events as assessed by the investigator as well as self-reported by the patient (during on-site visits or by phone calls) from signing the informed consent until the End of the Interventional period (EoI), i.e. until 4-weeks PT., Safety Endpoint - During the interventional study: Investigator’s assessment of local skin reactions using the Local Skin Reaction Scale (LRS) at every on-site visit during the treatment period and at 4-weeks PT., Safety Endpoint - During the interventional study: Investigator’s Global Tolerability Assessment (IGTA) at every on-site visit during the treatment period and at 4-weeks PT., Safety Endpoint - During the interventional study: Patient’s Global Tolerability Assessment (PGTA) at every on-site visit during the treatment period and at 4-weeks PT., Safety Endpoint - During the post-treatment FU: AEs (dermatological AEs on TA or outside TA [limited to the head] as well as any AEs with at least suspected relation to IP use, only) and all SAEs from 4-weeks PT until the end of the PTFU period., Safety Endpoint - During the post-treatment FU: Total number of SCCs in the TA during the course of the study (detected by visual inspection and subsequent removal for histological confirmation of diagnosis, according to general practice and in accordance with current guidelines)., Safety Endpoint - During the entire study period: Total number of SCCs on the head during the course of the study.

Source: https://euclinicaltrials.eu/ctis-public/view/2022-502811-12-00